EU clinical trial 2024-516600-42-00: A Pragmatic Randomized Trial to Evaluate the Vaccine Effectiveness of Abrysvo® for Preventing RSV Hospitalizations in Adults Aged 18 Years or Above (DAN-RSV)
Protocol code: DAN-RSV
Sponsor: Gentofte Hospital, Pfizer Inc. (Hospital/Clinic/Other health care facility, Pharmaceutical company). Phase: Therapeutic use (Phase IV). Countries: Denmark (ongoing, recruitment ended), Spain (ongoing, recruitment ended).
Therapeutic area(s): Diseases [C] - Virus Diseases [C02]
Gender: Female, Male. Age: 18-64 years, 65+ years. Enrolment: 890000.
Status: Ongoing, recruitment ended. Start date (EU): 2024-11-18. Decision date: 2024-10-14. Results received: No. Last updated: 2025-11-03.
Decision dates by country: DK: 2024-10-14, ES: 2025-11-03

Condition(s): RSV-infection
Product: Abrysvo powder and solvent for solution for injection Respiratory syncytial virus vaccine (bivalent, recombinant)

Primary endpoint: Hospitalization for RSV-related respiratory tract disease
Endpoint(s): Hospitalization for RSV-related respiratory tract disease evaluated among the as-treated study population with balanced follow up time between study arms (key secondary), RSV-related lower respiratory tract disease hospitalization (key secondary), Stratifications of the primary endpoint by a. Age group (60-74 and 75+) b. Subsequent seasons (2025/2026 and 2026/2027 RSV seasons), RSV-related hospitalization, All-cause respiratory tract disease hospitalization (key secondary), RSV-related cardio-respiratory hospitalizations, All-cause cardio-respiratory hospitalizations, All-cause lower respiratory tract disease hospitalization, All-cause hospitalization, All-cause death

Source: https://euclinicaltrials.eu/ctis-public/view/2024-516600-42-00